EU clinical trial 2025-524296-23-01: A multi-center, open label, longitudinal, observational, 12-week study of Flexilev treatment with the dosing device OraFID and accompanying digital app in Parkinson patients.
Protocol code: Nava-25-01
Sponsor: Navamedic AB (Pharmaceutical company). Phase: Therapeutic use (Phase IV). Countries: Sweden (ongoing, recruiting).
Therapeutic area(s): Diseases [C] - Nervous System Diseases [C10]
Gender: Female, Male. Age: 18-64 years, 65+ years. Enrolment: 58.
Status: Ongoing, recruiting. Start date (EU): 2026-05-26. Decision date: 2026-02-24. Results received: No. Last updated: 2026-04-22.

Condition(s): Parkinsons Disease
Product: Flexilev 5 mg/1,25 mg, dispergerbara tabletter för dosdispenser

Primary endpoint: Self-reported using questionnaire regarding the device (self-reported in Patients Own Registration in “Parkinsonregistret”)
Endpoint(s): Self-reported using questionnaire regarding the app (self-reported in Patients Own Registration in “Parkinsonregistret”), Self-reported using questionnaire regarding the device (self-reported in Patients Own Registration in “Parkinsonregistret”), Data obtained from the app Levilog and drug accountability records., Compliance with APP (Levilog) – and treatment data from use of APP (self-reported in Patients Own Registration in “Parkinsonregistret” + data obtained from the app), Safety reporting; adverse event and serious adverse events,withdrawals, Self-reported using questionnaire regarding the device (self-reported in Patients Own Registration in “Parkinsonregistret”), Self-reported using questionnaire regarding the device (self-reported in Patients Own Registration in “Parkinsonregistret”), NMSQ, Non-Motor Symptoms Questionnaire (NMSQ self-reported in Patients Own Registration in “Parkinsonregistret”)., HADS-D, Hospital Anxiety and Depression Scale, (HADS-D self-reported in Patients Own Registration in “Parkinsonregistret”)., PDQ-8, Parkinson's disease quality-of-life scale, and the EQ5D-5L (EuroQol) generic quality of life scale, together with the associated 0 to 100-point visual analog scale (VAS), (self-reported in Patients Own Registration in “Parkinsonregistret”)., OnOff - Self-reported OnOff Scale questionnaire (OnOff self-reported in Patients Own Registration in “Parkinsonregistret”)., OnOff - Self-reported OnOff Scale questionnaire (OnOff self-reported in Patients Own Registration in “Parkinsonregistret”)., PDSS-2 questionnaire (PDSS-2 self-reported in Patients Own Registration in “Parkinsonregistret”)., OnOff - Self-reported OnOff Scale questionnaire (OnOff self-reported in Patients Own Registration in “Parkinsonregistret”)., UPDRS, Unified Parkinson’s Disease Rating Scale (Physician reported in “Parkinsonregistret”), UPDRS, Unified Parkinson’s Disease Rating Scale (Physician reported in “Parkinsonregistret”), CISI-PD, Clinical Impression of Severity Index for Parkinson’s Disease (Physician reported in “Parkinsonregistret”), The PRO-PD, Patient-Reported Outcomes in Parkinson's Disease, (PRO-PD self-reported in Patients Own Registration in “Parkinsonregistret”).

Source: https://euclinicaltrials.eu/ctis-public/view/2025-524296-23-01